EU clinical trial 2026-525909-13-00: Do GLP-1 based therapies improve the immunological response to vaccination in diabetes?
Protocol code: R0132901
Sponsor: Radboud universitair medisch centrum Stichting (Hospital/Clinic/Other health care facility). Phase: Therapeutic use (Phase IV). Countries: Netherlands (authorised, recruitment pending).
Therapeutic area(s): Diseases [C] - Immune System Diseases [C20]; Diseases [C] - Hormonal diseases [C19]
Gender: Female, Male. Age: 18-64 years, 65+ years. Enrolment: 100.
Status: Authorised, recruitment pending. Decision date: 2026-07-22. Results received: No. Last updated: 2026-07-22.

Condition(s): Diabetes
Product: Pneumovax 23, oplossing voor injectie in een voorgevulde spuit Pneumokokkenpolysacharidevaccin, Victoza 6 mg/ml solution for injection in pre-filled pen

Primary endpoint: The fold-increase in total pneumococcal IgG antibody levels four months after vaccination.
Endpoint(s): The fold-increase in total IgG antibody levels one month after pneumococcal vaccination, The fold-increase in serotype specific antibody levels after pneumococcal vaccination, Effects of GLP-1 on (1) plasma inflammation markers, (2) immune cell numbers and (3) leukocyte ex vivo function, Questionnaire regarding vaccine-related solicited adverse events, Hospitalisation, ICU admission or death due to infectious disease

Source: https://euclinicaltrials.eu/ctis-public/view/2026-525909-13-00